EU clinical trial 2023-504863-17-00: A Multicenter, Open-Label, Single-Arm, Phase 3, Long-Term Extension Study to Evaluate Continuous Safety and Efficacy of BIIB059 (Litifilimab) in Adult Participants With Active Subacute Cutaneous Lupus Erythematosus and/or Chronic Cutaneous Lupus Erythematosus With or Without Systemic Manifestations and Refractory and/or Intolerant to Antimalarial Therapy (AMETHYST LTE)
Protocol code: 230LE305
Sponsor: Biogen Idec Research Limited (Pharmaceutical company). Phase: Therapeutic confirmatory (Phase III). Countries: Italy (ongoing, recruiting), Slovakia (ongoing, recruiting), Germany (ongoing, recruiting), Poland (ongoing, recruiting), Hungary (ongoing, recruiting), Portugal (ongoing, recruiting), Sweden (ongoing, recruiting), Spain (ongoing, recruiting), France (ongoing, recruiting), Bulgaria (ongoing, recruiting), Belgium (authorised, recruitment pending).
Therapeutic area(s): Diseases [C] - Immune System Diseases [C20]
Gender: Female, Male. Age: 18-64 years, 65+ years. Enrolment: 202.
Start date (EU): 2024-02-21. Decision date: 2023-12-18. Results received: No. Last updated: 2026-07-06.
Decision dates by country: FR: 2024-01-03, SK: 2023-12-18, SE: 2023-12-20, DE: 2023-12-19, BE: 2026-01-23, BG: 2024-01-08, IT: 2023-12-18, PT: 2024-01-08, ES: 2024-01-08, PL: 2023-12-21, HU: 2023-12-20

Condition(s): 1. Lupus Erythematosus, Cutaneous, Subacute; 2. Chronic Cutaneous Lupus Erythematosus
Product: BIIB059

Primary endpoint: Number of Participants With Treatment-Emergent Adverse Events (TEAEs) and Serious Adverse Events (SAEs) [Time Frame: Up to 128 weeks]
Endpoint(s): Percentage of Participants who Achieve a Cutaneous Lupus Erythematosus Disease Area and Severity Index Activity Score (CLASI)-70 Response, Defined as a 70% Improvement in CLASI-A Score from the Baseline Value (Parent Study) [Time Frame: Up to 128 weeks], Percentage of Participants who Achieve a CLASI-50 Response, Defined as a 50% Improvement in CLASI-A Score from the Baseline Value (Parent Study) [Time Frame: Up to 128 weeks], Percentage of Participants who Achieve a CLASI-90 Response, Defined as a 90% Improvement in CLASI-A Score from the Baseline Value (Parent Study) [Time Frame: Up to 128 weeks], Percentage of Participants who Achieve a Cutaneous Lupus Activity of Physician's Global Assessment-Revised (CLA-IGA-R) Erythema Score of 0 or 1 [Time Frame: Up to 128 weeks], Percentage of Participants who Achieve a CLA-IGA-R Other Morphologic Characteristics (OMC) Score of 0 or 1 [Time Frame: Up to 128 weeks], Cumulative Duration of Sustained CLASI-70 Response, Defined as the Number of Weeks With 70%Improvement in CLASI-A Score from the Baseline Value (Parent Study) [Time Frame: Up to 128 weeks], Cumulative Duration of Sustained CLASI-50 Response, Defined as the Number of Weeks With 50%Improvement in CLASI-A Score from the Baseline Value (Parent Study) [Time Frame: Up to 128 weeks], Cumulative Duration of Sustained CLASI-90 Response, Defined as the Number of Weeks With 90%Improvement in CLASI-A Score From the Baseline Value (Parent Study) [Time Frame: Up to 128 weeks], Cumulative Duration of Sustained Efficacy, Defined as the Number of Weeks With CLA-IGA-R Erythema Score of 0 or 1 [Time Frame: Up to 128 weeks], Cumulative Duration of Sustained Efficacy, Defined as the Number of Weeks With CLA-IGA-R OMC Score of 0 or 1 and Improvement of at Least 1 Point From Baseline Value (Parent Study) [Time Frame: Up to 128 weeks], Cumulative Duration of Sustained Efficacy, Defined as the Number of Weeks With CLA-IGA-R Follicular Activity Score of 0 [Time Frame: Up to 128 weeks], Percentage of Participants With a CLASI-70 Response Among CLASI-70 Responders at Week 52 of the Parent Study [Time Frame: Day 0 (Week 52 of parent study) up to 128 weeks], Percentage of Participants With a CLASI-50 Response Among CLASI-50 Responders at Week 52 of the Parent Study [Time Frame: Day 0 (Week 52 of parent study) up to 128 weeks], Percentage of Participants With a CLASI-90 Response Among CLASI-90 Responders at Week 52 of the Parent Study [Time Frame: Day 0 (Week 52 of parent study) up to 128 weeks], Percentage of Participants With a CLA-IGA-R Erythema Score of 0 or 1 Among Participants With aCLA-IGA-R Erythema Score of 0 or 1 at Week 52 of the Parent Study [Time Frame: Day 0 (Week 52 of parent study) up to 128 weeks], Percentage of Participants With a CLA-IGA-R OMC Score of 0 or 1 and at Least 1 Level of Improvement From Baseline Value (Parent Study) Among Participants With a CLA IGA R OMC Score of 0 or 1 and at Least 1 Level of Improvement From Baseline Value (Parent Study) [Time Frame: Day 0 (Week 52 of parent study) up to 128 weeks], Percentage of Participants With a CLASI-70 Response Among CLASI-50 Responders at Week 52 of the Parent Study [Time Frame: Day 0 (Week 52 of parent study) up to 128 weeks], Percentage of Participants With a CLASI-90 Response Among CLASI-50 Responders at Week 52 of the Parent Study [Time Frame: Day 0 (Week 52 of parent study) up to 128 weeks], Percentage of Participants With a CLASI-90 Response Among CLASI-70 Responders at Week 52 of the Parent Study [Time Frame: Day 0 (Week 52 of parent study) up to 128 weeks], Percentage of Participants With Loss of Response, Defined as an Increase of ≥ 7 Points in CLASI-A Total Score From Baseline [Time Frame: Baseline (Day 0) up to 128 weeks], Percentage of Participants With Loss of Response, Defined as Achieving 2 Points Improvement From Baseline Value (Parent Study) CLA-IGA-R Erythema Score at the Beginning of/ During the LTE Study and Then Relapsing to the CLA-IGA-R Erythema Baseline Value (Parent Study) [Time Frame: Up to 128 weeks], Percentage of Participants With Loss of Response, Defined as Having at Least 2, 3, and 4 Points Worsening in CLA-IGA-R Erythema Score From Their Minimum Score in Parent Study [Time Frame: Up to 128 weeks], Absolute Change in Cutaneous Lupus Erythematosus Disease Area and Severity Index Damage (CLASI-D) Score From the Baseline (Parent Study) to Week 104 [Time Frame: Up to 104 weeks], Percent Change in CLASI-D Score From the Baseline (Parent Study) to Week 104 [Time Frame: Up to 104 weeks], Annualized Mild/Moderate and Severe Safety of Estrogens in Lupus Erythematosus National Assessment-SLE Disease Activity Index Flare Index (SFI) Rates Through Week 52 [Time Frame: Up to 52 weeks], Annualized Mild/Moderate and Severe SFI Rates Through Week 104 [Time Frame: Up to 104 weeks], Percentage of Participants With Oral Corticosteroid (OCS) Dose [Time Frame: Up to 104 weeks], Percentage of Participants With OCS ≤ 7.5 Milligrams per day (mg/day) [Time Frame: Up to 104 weeks], Percentage of Participants With OCS ≤ 5.0 mg/day [Time Frame: Up to 104 weeks], Change From Baseline Value (Parent Study) in Cutaneous Lupus Erythematosus –Quality of Life (CLE-QoL) at Weeks 52 and 104 [Time Frame: Baseline, Weeks 52 and 104], Change From Baseline Value (Parent Study) in European Quality of Life – 5-Dimensions Questionnaire, 3-Level Version (EQ-5D-3L) at Weeks 52 and 104 [Time Frame: Baseline, Weeks 52 and 104], Change From Baseline Value (Parent Study) in 36-Item Short Form Survey (SF-36)(acute version) at Weeks 52 and 104 [Time Frame: Baseline, Weeks 52 and 104], Change From Baseline Value (Parent Study) in Work Productivity and Activity Impairment (WPAI): Lupus at Weeks 52 and 104 [Time Frame: Baseline, Weeks 52 and 104], Change From Baseline Value (Parent Study) in Patient Health Questionnaire-9(PHQ-9) at Weeks 52 and 104 [Time Frame: Baseline, Weeks 52 and 104], Number of Participants With Clinically Relevant Change From Baseline Value (Parent Study) in Standard Laboratory Parameters [Time Frame: Up to 128 weeks], Number of Participants With Clinically Relevant Change From Baseline Value (Parent Study) in ECG Results [Time Frame: Up to 104 weeks], Number of Participants With Anti-BIIB059 (litifilimab) Antibodies in Serum [Time Frame: Up to 128 weeks], Serum Concentration of Litifilimab [Time Frame: Pre-dose up to 128 weeks], Change From Baseline Value (Parent Study) in Subject Global Assessment of Skin - Follow-up (SGA-Skin-FU) at Weeks 52 and 104 [Time Frame: Baseline, Weeks 52 and 104], Change From Baseline Value (Parent Study) in Numerical Rating Scale (NRS) for Pain in Skin Rash at Weeks 52 and 104 [Time Frame: Baseline, Weeks 52 and 104], Change From Baseline Value (Parent Study) in Numerical Rating Scale (NRS) for Itch in Skin Rash at Weeks 52 and 104 [Time Frame: Baseline, Weeks 52 and 104]

Source: https://euclinicaltrials.eu/ctis-public/view/2023-504863-17-00